EU clinical trial 2024-515722-83-00: SERRATUS : Evaluation of the Analgesia by Serratus Plane Block During Pleural Drainage in Intensive Care Unit.
Sponsor: Centre Hospitalier Universitaire Amiens Picardie (Hospital/Clinic/Other health care facility). Phase: Therapeutic confirmatory (Phase III). Countries: France (authorised, recruitment pending).
Therapeutic area(s): Diseases [C] - Nervous System Diseases [C10]
Gender: Female, Male. Age: 18-64 years, 65+ years. Enrolment: 70.
Status: Authorised, recruitment pending. Decision date: 2024-07-30. Results received: No. Last updated: 2024-07-30.

Condition(s): Anesthesia /Intensive care
Product: DEXAMETHASONE SODIUM PHOSPHATE, ROPIVACAINE, LIDOCAINE HYDROCHLORIDE, ROPIVACAINE

Primary endpoint: Intensity of acute pain during pleural drainage (H0) by numerical scale (EN).
Endpoint(s): Intensity of acute pain by EN at rest and during exercise (forced inspiration) at the end of pleural drainage (H0)., Intensity of acute pain from EN at rest and during exercise (cough and forced inspiration) after drainage over the first 24 hours (H0, H1, H6, H24)., Clinical tolerance at the end of drainage (H0): MAP HR, FR, SpO2., Lung capacity in milliliters measured by the Voldyne (maximum inspired volume) H1, H6, H24., Respiratory complications: - atelectasis = auscultation + radiography or ultrasound - nosocomial pneumonia = 3 clinicoradiological criteria compatible with radiological infiltrate + hyperthermia (>38 or <36°C) or leukocytes (>12000 or <4000 GB/mm3) + purulent aspirations or suggestive auscultation or hypoxemia., Use of tracheal intubation., Early rehabilitation: time to first getting up, physiotherapy., Duration of drainage., Duration of stay in intensive care., Duration of installation of anesthesia.

Source: https://euclinicaltrials.eu/ctis-public/view/2024-515722-83-00